EU clinical trial 2025-525069-65-00: ERPPAD - Efficacy in Relapse Prevention: Psilocybin in Alcohol use disorder with Depressive symptoms
Sponsor: Centre Hospitalier Universitaire De Nimes (Hospital/Clinic/Other health care facility). Phase: Therapeutic confirmatory (Phase III). Countries: France (ongoing, recruiting).
Therapeutic area(s): Psychiatry and Psychology [F] - Mental Disorders [F03]
Gender: Female, Male. Age: 18-64 years, 65+ years. Enrolment: 172.
Status: Ongoing, recruiting. Start date (EU): 2026-06-24. Decision date: 2026-06-05. Results received: No. Last updated: 2026-06-05.

Condition(s): Alcohol use disorder, depressive symptoms
Product: PSILOCYBINE, PSILOCYBINE

Primary endpoint: Time to relapse is defined as the 1st heavy drinking day (HDD), i.e., ≥60g alcohol. Alcohol consumption will be collected every 6 weeks using the Timeline Follow-Back (TLFB) method, with the assistance of either a digital or paper calendar.
Endpoint(s): By group HD and LD will be assessed at weeks 0, 3, 9, 15, 21, 27 : TLFB, CEQ, AQoLS- brief, BDI-II, BAI, DERS, A-RSQ, PCL-5, VPT only week 0, 3 and 28., By group HD and LD, the proportion and characteristics of participants requesting a 3rd dose of 25mg psilocybin will be assessed at weeks 27 : TLFB, CEQ, AQoLS- brief, BDI-II, BAI, DERS, A-RSQ, PCL-5, preference for a 3rd dose, Administration of a 3rd dose, In the subgroups of non-relapsers at 6 months from LD and HD, and in the subgroups “administration 3rd dose” vs “no 3rd dosewill be assessed at weeks 27, 33, 39, 45, 51 : TLFB, CEQ, AQoLS- brief, BDI-II, BAI, DERS, A-RSQ, PCL-5, In the subgroups of relapsers at 6 months from LD and HD, and in the subgroups “administration 3rd dose” vs “no 3rd dose” will be assessed at weeks 27, 33, 39, 45, 51 : TLFB, CEQ, AQoLS- brief, BDI-II, BAI, DERS, A-RSQ, PCL-5, In the high dose group: changes from baseline between 6-12 months in the subgroups A3D vs. N3D and in the whole group will be assessed : TLFB, CEQ, AQoLS-brief, BDI-II, BAI, DERS, A-RSQ, PCL-5., Potential response factors: ACE, RSQ, MoCA will be assessed only at baseline. PCL-5 will be administered at week 0 and all the follow-up visits. APEQ will be administered prior to the start of each integration session, others patient's caracteristics, Serious adverse events, In the groups HD or LD and subgroups relapsers or no-relapsers describe changes of blood samples between baseline and week 28

Source: https://euclinicaltrials.eu/ctis-public/view/2025-525069-65-00